EU clinical trial 2023-507894-16-00: Improving public cancer care by implementing precision medicine in Norway A multi-cohort phase 2 treatment clinical study investigating efficacy of approved drugs outside indication in patients with advanced cancer. IMPRESS-Norway
Sponsor: Oslo University Hospital HF (Hospital/Clinic/Other health care facility). Phase: Therapeutic exploratory (Phase II). Countries: Norway (ongoing, recruiting).
Therapeutic area(s): Diseases [C] - Neoplasms [C04]
Gender: Female, Male. Age: 18-64 years, 65+ years. Enrolment: 1000.
Status: Ongoing, recruiting. Start date (EU): 2021-04-01. Decision date: 2024-08-23. Results received: No. Last updated: 2026-05-26.

Condition(s): Cancer
Product: Zelboraf 240 mg film-coated tablets, Tecentriq 1 875 mg solution for injection, HYDROXYCARBAMIDE, Tafinlar 75 mg hard capsules, Retsevmo 80 mg hard capsules, Lynparza 100 mg film-coated tablets, Erivedge 150 mg hard capsules, Fulvestrant SUN 250 mg injeksjonsvæske, oppløsning i ferdigfylt sprøyte, Rozlytrek 200 mg hard capsules, DEXAMETHASONE, Avastin 25 mg/ml concentrate for solution for infusion., IMATINIB, MELPHALAN, Lynparza 150 mg film-coated tablets, Piqray 150 mg film-coated tablets, Mekinist 2 mg film-coated tablets, Tabrecta 150 mg film-coated tablets, DACTINOMYCIN, Alecensa 150 mg hard capsules, Tecentriq 1 200 mg concentrate for solution for infusion, CERITINIB, Pemazyre 4.5 mg tablets, Mekinist 0.5 mg film-coated tablets, AMIVANTAMAB, Retsevmo 40 mg hard capsules, Tabrecta 200 mg film-coated tablets, Tafinlar 50 mg hard capsules, NIRAPARIB, Tecentriq 840 mg concentrate for solution for infusion, BORTEZOMIB, TEPMETKO 225 mg film-coated tablets, DOSTARLIMAB, Piqray 200 mg film-coated tablets, Phesgo 1200 mg/600 mg solution for injection, Phesgo 600 mg/600 mg solution for injection, Piqray 50 mg and 200 mg film-coated tablets, Rozlytrek 100 mg hard capsules, IMATINIB, Cotellic 20 mg film-coated tablets, AMIVANTAMAB, Avastin 25 mg/ml concentrate for solution for infusion.

Primary endpoint: Number of patients that are included and treated based on their molecular tumour profile; (from protocol V10.0 onwards), Percentage of patients that are included and treated based on their molecular tumour profile; (protocol till version 10.0, Treatment-related grade ≥3 and serious adverse events, Disease control (objective complete or partial response or stable disease) at 16 weeks after treatment initiation according to established response criteria;
Endpoint(s): Progression-free and overall survival, Duration of time on drug, Time from the molecular diagnostics first informed consent to starting treatment (Protocol version V1-9)

Source: https://euclinicaltrials.eu/ctis-public/view/2023-507894-16-00